EU clinical trial 2024-512650-21-00: An Open-label Extension Study for Participants who Completed Study IMVT-1401-3201 or Study IMVT-1401-3202 to Assess the Efficacy and Safety of Batoclimab for the Treatment of Thyroid Eye Disease (TED)
Protocol code: IMVT-1401-3203
Sponsor: Immunovant Sciences GmbH (Pharmaceutical company). Phase: Therapeutic confirmatory (Phase III). Countries: Slovakia (ended), Hungary (ended), Belgium (ended), Italy (ended), Latvia (ended), Spain (ended), Poland (ended).
Therapeutic area(s): Diseases [C] - Eye Diseases [C11]
Gender: Female, Male. Age: 18-64 years, 65+ years. Enrolment: 73.
Status: Ended. Start date (EU): 2023-12-13. End date (EU): 2026-04-02. End date: 2026-04-03. Decision date: 2024-07-15. Results received: No. Last updated: 2025-10-08.
Decision dates by country: HU: 2024-07-16, SK: 2024-07-19, LV: 2024-07-15, ES: 2024-07-16, IT: 2024-08-06, PL: 2024-08-06, BE: 2024-07-17

Condition(s): Thyroid Eye Disease (TED)
Product: Batoclimab

Primary endpoint: Duration of proptosis response off treatment in study eye in participants who were batoclimab responders in the feeder studies.
Endpoint(s): Proportion of proptosis responders at Week 24 in study eye in participants who were placebo non-responders in the feeder studies., Proportion of proptosis responders at Week 24 in study eye in participants who were batoclimab non-responders in the feeder studies.

Source: https://euclinicaltrials.eu/ctis-public/view/2024-512650-21-00